EU clinical trial 2023-507786-26-00: Comparison of 18F-Fluciclovine PET versus 18F-Fluoroethyltyrosine PET in patients with newly diagnosed cerebral gliomas, recurrent cerebral gliomas and brain metastases – an open label single centre single arm prospective basket trial
Protocol code: 23-096
Sponsor: Universitaetsklinikum Aachen AöR (Hospital/Clinic/Other health care facility). Phase: Therapeutic exploratory (Phase II). Countries: Germany (ended).
Therapeutic area(s): Analytical, Diagnostic and Therapeutic Techniques and Equipment [E] - Diagnosis [E01]
Gender: Female, Male. Age: 18-64 years, 65+ years. Enrolment: 80.
Status: Ended. Start date (EU): 2024-08-14. End date (EU): 2026-04-02. Decision date: 2024-03-11. Results received: No. Last updated: 2025-08-26.

Condition(s): Patients with newly diagnosed cerebral gliomas, recurrent cerebral gliomas and brain metastases.
Product: Axumin 1,600 MBq/mL solution for injection, Axumin 3,200 MBq/mL solution for injection, FET

Primary endpoint: The primary endpoint is the agreement of the diagnosis of tumour size and tracer distribution in FET PET with FACBC PET in the examined patients based on consensus voting in the classification categories A or B by three examiners. Categories C and D will be assessed as disagreement.
Endpoint(s): Significant correlation of the tumour-to-brain ratios in FET and FACBC PET., Similar differences of Time-to-peak (TTP) and slope of the time-activity-curve (TAC) of FET and FACBC uptake in highgrade and low-grade gliomas., Similar accuracy of FET and FACBC PET in differentiating tumour progression (TP) and treatment related changes (TRC) in recurrent gliomas and brain metastases., Similar differences of TTP and slope of the TAC of FET and FACBC uptake in TP and TRC in recurrent gliomas and brain metastases.

Source: https://euclinicaltrials.eu/ctis-public/view/2023-507786-26-00